EU clinical trial 2024-519017-62-00: DETECTION RATE AND CLASSIFICATION OF BREAST LESIONS WITH DIGITAL MAMMOGRAPHY WITH CONTRAST MEDIUM (CEDM) ALONE AND IN COMBINATION WITH TOMOSYNTHESIS COMPARED TO MR IMAGING WITH GADOLINIUM IN DYNAMICS (DCE-MRI) - CEDM-MRI
Sponsor: IRCCS Istituto Nazionale Tumori Fondazione Pascale (Hospital/Clinic/Other health care facility). Phase: Therapeutic exploratory (Phase II). Countries: Italy (authorised, recruitment pending).
Therapeutic area(s): Diseases [C] - Neoplasms [C04]
Gender: Female. Age: 18-64 years, 65+ years. Enrolment: 400.
Status: Authorised, recruitment pending. Decision date: 2025-01-08. Results received: No. Last updated: 2025-06-17.

Condition(s): breast pathology
Product: Ultravist 370 mg/ml soluzione iniettabile, OMNIPAQUE 350 mg I/ml soluzione iniettabile, VISIPAQUE 320 mg I/ml soluzione iniettabile

Primary endpoint: Equivalence/Comparability of CEDM alone and in combination with DBT compared to Contrast-Enhanced MRI (CE-MRI) in terms of detection rate and diagnostic accuracy.
Endpoint(s): Evaluation of the diagnostic accuracy of a radiomic signature of morphological and textural features extracted from the three modalities (CEDM, DBT, and MRI) in the classification of breast lesions in terms of benignity, malignancy, grade, and tumor phenotype (luminal A, luminal B, HER2+, triple negative).

Source: https://euclinicaltrials.eu/ctis-public/view/2024-519017-62-00